EU clinical trial 2024-510871-39-00: A Phase 2, Double-blind, Dose-Ranging, Parallel, Long-term Extension Study to Evaluate the Safety and Efficacy of Enpatoran in Participants with Subacute Cutaneous Lupus Erythematosus, Discoid Lupus Erythematosus and/or Systemic Lupus Erythematosus Having Completed the WILLOW (MS200569_0003) Study Treatment (WILLOW LTE)
Protocol code: MS200569_0048
Sponsor: Merck Healthcare KGaA (Pharmaceutical company). Phase: Therapeutic exploratory (Phase II). Countries: Greece (ongoing, recruitment ended), Poland (ongoing, recruitment ended), Romania (ongoing, recruitment ended), Spain (ongoing, recruitment ended), Bulgaria (ongoing, recruitment ended).
Therapeutic area(s): Diseases [C] - Immune System Diseases [C20]; Diseases [C] - Skin and Connective Tissue Diseases [C17]
Gender: Female, Male. Age: 18-64 years, 65+ years. Enrolment: 65.
Status: Ongoing, recruitment ended. Start date (EU): 2022-11-21. Decision date: 2024-07-17. Results received: No. Last updated: 2026-05-11.
Decision dates by country: PL: 2024-07-18, BG: 2024-07-17, RO: 2024-07-23, GR: 2024-08-22, ES: 2024-07-17

Condition(s): Systemic lupus erythematosus (SLE) and cutaneous lupus erythematosus (CLE)
Product: Enpatoran Placebo, Enpatoran

Primary endpoint: Part 1: Safety Profile as Assessed by Incidence of Treatment-Emergent Adverse Events (TEAEs), Serious Adverse Events (SAEs), Adverse Event of Special Interest (AESIs), Part 2: Safety Profile as Assessed by Incidence of Treatment-Emergent Adverse Events (TEAEs), Serious Adverse Events (SAEs), Adverse Event of Special Interest (AESIs)
Endpoint(s): Part 1 and Part 2: Number of Participants with Abnormalities in Laboratory Parameters and QT Interval Corrected

Source: https://euclinicaltrials.eu/ctis-public/view/2024-510871-39-00